EU clinical trial 2024-514874-36-01: Endocardial Delivery of XC001 Gene Therapy for Refractory Angina Coronary Treatment: A 26-Week (with 26 Week Extension) Phase 2b Randomized, Multi-Center, Double-Blind, Sham Controlled Study to Evaluate Efficacy and Safety (EXACT-2 Trial)
Protocol code: XC001-1002
Sponsor: Xylocor Therapeutics Inc. (Pharmaceutical company). Phase: Therapeutic exploratory (Phase II). Countries: Belgium (authorised, recruitment pending), Poland (ongoing, recruiting), Hungary (ongoing, recruiting), Netherlands (ongoing, recruiting), Germany (authorised, recruitment pending).
Therapeutic area(s): Diseases [C] - Cardiovascular Diseases [C14]
Gender: Female, Male. Age: 18-64 years, 65+ years. Enrolment: 84.
Start date (EU): 2026-04-17. Decision date: 2025-11-04. Results received: No. Last updated: 2026-05-19.
Decision dates by country: PL: 2025-11-07, HU: 2025-11-10, BE: 2025-11-04, DE: 2025-11-07, NL: 2025-11-05

Condition(s): Refractory angina due to obstructive coronary artery disease
Product: Ammonia 13N, XC001, Flurpiridaz F 18

Primary endpoint: (Part 2 only) The primary composite endpoint is the average of the proportions of subjects with a therapy response at Week 12 and the proportion of subjects with a therapy response at Week 26 for XC001, as compared to the sham procedure group. All ETT and imaging analysis will be assessed by blinded core labs.
Endpoint(s): (Part 2 only) Difference in percentage of subjects with a therapy response as compared to the sham procedure group (each timepoint will be analyzed separately) at 12 and 26 weeks separately, as well as at 52 weeks in the extension period, (Part 2 only) Average of changes from baseline to 12 and 26 weeks, as well as at week 52 in the extension period, as compared to sham procedure in TED on a Modified Bruce protocol ETT, (Part 2 only) Change from baseline to 12 and 26 weeks (as well as to week 52 in the extension period) as compared to sham procedure in TED on a Modified Bruce protocol, (Part 2 only) Change from baseline (% relative change) to 12 and 26 weeks separately, (as well as to the week 52 in the extension period) as compared to sham procedure in the frequency of angina episodes, severity and nitroglycerin (NTG) use over a 2-week observation period (The 2-week time period prior to Week 12 and 26 will be extracted from the daily collection of angina episodes and nitroglycerin use), (Part 2 only) Change from baseline (% relative change) to 12 and 26 weeks (as well as to week 52 in the extension period) as compared to sham control procedure in regional CFR and TPD as measured by PET (including MBF and myocardial flow reserve [MFR]), (Part 2 only) Change from baseline to Weeks 12, and 26 (as well as to week 52 in the extension period) as compared to sham procedure in angina class as measured by the CCS Functional Classification of Angina Pectoris, (Part 2 only) Change from baseline to weeks 12 and 26 (as well as to week 52 in the extension period) as compared to sham procedure in time-to-angina during the Modified Bruce protocol ETT, (Part 2 only) Change from baseline to weeks 12 and 26 ( as well as to week 52 in the extension period) in time-to-1 mm ST depression on ETT 12lead ECG, (Part 2 only) Change from baseline to weeks 12 and 26 (as well as to week 52 in the extension period) as compared to sham procedure in the use of anti-anginal agents and the quantity and frequency of use of prophylactic/as needed (prn) nitroglycerin (% relative change), (Part 2 only) Change from baseline to weeks 12 and 26 (as well as to week 52 in the extension study) as compared to sham procedure in SAQ score and in the EQ-5D-3L questionnaire, (Part 2 only) Change from baseline up to weeks 12 and 26 (as well as up to week 52 in the extension period) as compared to sham procedure in modified MACE frequency. Modified MACE is defined as any cardiovascular death, acute MI, any revascularization procedure, emergency room (ER) visits or hospitalization due to acute coronary syndrome (ACS), unstable angina (UAP), or heart failure, (Part 2 only) Change from baseline up to weeks 12 and 26 (as well as up to week 52 in the extension period) compared to sham procedure in time to first modified MACE, (Part 2 only) Comparison of all-cause and cardiovascular mortality between the treatment group and the sham group up to weeks 12 and 26 (as well as up to week 52 in the extension period), (Part 2 only) Change from baseline up to weeks 12 and 26 of daily angina frequency (% relative change), angina severity, sublingual (sl) nitroglycerin use and number of angina-free days using an electronic diary, (Part 2 only) To evaluate device handling, performance, and usability of the delivery catheter (Extroducer®) during the delivery procedure, Safety Endpoints (Part 1 and Part 2): Investigational Product - Safety through Week 26 (as well as through week 52 in the extension period). All drug-related SAEs up to 26 weeks (and 52 weeks in the extension period) post-procedure as adjudicated by IDMC., Safety Endpoints (Part 1 and Part 2): Investigational Device - All investigational device-related TESAEs up to 4 weeks post-procedure (i.e., serious adverse device effects) as adjudicated by IDMC., Safety Endpoints (Part 1 and Part 2): Additional safety endpoints - AE’s (including trends as identified by IDMC); hematology; clinical chemistry (including high sensitivity troponin), and anti-Ad5 neutralizing antibodies and

Source: https://euclinicaltrials.eu/ctis-public/view/2024-514874-36-01